EU clinical trial 2025-524814-27-00: Phase I, first-in-human clinical trial to evaluate safety of infusion of STAb-T19 cells: genetically modified T lymphocytes secreting αCD19xαCD3 bispecific antibodies for malignant B-cell neoplasms
Protocol code: H12O-STAb-T-001
Sponsor: Fundacion Para La Investigacion Biomédica Del Hospital Universitario 12 De Octubre (Patient organisation/association). Phase: Human Pharmacology (Phase I)- First administration to humans. Countries: Spain (authorised, recruitment pending).
Therapeutic area(s): Diseases [C] - Hemic and Lymphatic Diseases [C15]; Diseases [C] - Neoplasms [C04]
Gender: Female, Male. Age: 18-64 years, 65+ years. Enrolment: 24.
Status: Authorised, recruitment pending. Decision date: 2026-04-22. Results received: No. Last updated: 2026-07-09.
Decision dates by country: ES: 2026-05-22

Condition(s): Malignant B-cell neoplasms

Source: https://euclinicaltrials.eu/ctis-public/view/2025-524814-27-00